EU clinical trial 2023-506893-11-00: A Multicentre, Randomised, Double-blind, Placebo-controlled, Phase IIb Study to Evaluate the Safety of Zibotentan/Dapagliflozin in Combination Compared to Zibotentan Monotherapy as well as Zibotentan/Dapagliflozin and Zibotentan Monotherapy Compared to Placebo in Participants with Cirrhosis
Protocol code: ZEAL-UNLOCK
Sponsor: Astrazeneca AB (Pharmaceutical company). Phase: Therapeutic exploratory (Phase II). Countries: Belgium (ended), Slovakia (ended), Czechia (ended), Germany (ended), Italy (ended), Poland (ended).
Therapeutic area(s): Diseases [C] - Digestive System Diseases [C06]
Gender: Female, Male. Age: 18-64 years, 65+ years. Enrolment: 36.
Status: Ended. Start date (EU): 2024-04-19. End date (EU): 2024-12-09. End date: 2024-12-12. Decision date: 2024-04-02. Results received: Yes. Last updated: 2024-12-11.
Decision dates by country: PL: 2024-05-15, BE: 2024-04-02, IT: 2024-04-08, DE: 2024-04-05, CZ: 2024-04-03, SK: 2024-04-08

Condition(s): Cirrhosis of the liver is a condition in which the liver is scarred and damaged
Product: Zibotentan, DAPAGLIFLOZIN, Zibotentan placebo, Dapagliflozin placebo

Primary endpoint: Occurrence of any of the following components of this composite endpoint from baseline to Week 6: > 2 kg increase in body weight (office-based), Occurrence of any of the following components of this composite endpoint from baseline to Week 6: > 2 L increase in total body water, Occurrence of any of the following components of this composite endpoint from baseline to Week 6: Increase in 2 or more loop-diuretic equivalents, Occurrence of any of the following components of this composite endpoint from baseline to Week 6:Fluid retention adverse event (AE), Occurrence of any of the following components of this composite endpoint from baseline to Week 6: > 2 kg increase in body weight (office-based), Occurrence of any of the following components of this composite endpoint from baseline to Week 6: > 2 L increase in total body water, Occurrence of any of the following components of this composite endpoint from baseline to Week 6: Increase in 2 or more loop-diuretic equivalents, Occurrence of any of the following components of this composite endpoint from baseline to Week 6:Fluid retention adverse event (AE), Change in body weight (kg) over time course of study (home-based monitoring)., Change from baseline in body weight, total body water, extracellular and intracellular water volumes, and body fat mass at Week 6 (office-based monitoring)., Change in total dosage of loop-diuretic equivalents use from baseline to Week 6., Occurrence of either of the two components of this composite: > 3 L increase in total body water volume from baseline to Week 6., Occurrence of either of the two components of this composite: Increase in 3 or more loop-diuretic equivalents use from baseline to Week 6., Absolute change in systolic and diastolic blood pressure from baseline to Week 6.
Endpoint(s): AEs, SAEs, and DAEs, AESIs (new or worsening HF; other signs of fluid retention; orthostatic hypotension; UTI; GI; AKI), Vital signs, Safety laboratory tests, ECG assessments

Source: https://euclinicaltrials.eu/ctis-public/view/2023-506893-11-00